EU clinical trial 2024-517526-26-00: A Randomized, Double-Blind Evaluation of the Antiviral Efficacy, Safety, and Tolerability of Tenofovir Disoproxil Fumarate Versus Placebo in Pediatric Patients with Chronic Hepatitis B Infection
Protocol code: GS-US-174-0144
Sponsor: Gilead Sciences Inc. (Pharmaceutical company). Phase: Therapeutic confirmatory (Phase III). Countries: Romania (ended).
Therapeutic area(s): Diseases [C] - Virus Diseases [C02]
Gender: Female, Male. Age: 0-17 years. Enrolment: 23.
Status: Ended. Start date (EU): 2012-12-06. End date (EU): 2025-06-05. Decision date: 2024-11-07. Results received: No. Last updated: 2024-11-07.

Condition(s): Hepatitis B Infection
Product: Viread 245 mg film-coated tablets, Viread 123 mg film-coated tablets, Viread 204 mg film-coated tablets, PTM Tenofovir DF, Viread 163 mg film-coated tablets, Viread 33 mg/g granules

Primary endpoint: Percentage of Participants With Serum HBV DNA < 400 Copies/mL (69 IU/mL) at Week 48 (Missing = Failure Approach) [Time Frame: Week 48], Percentage of Participants With Serum HBV DNA < 400 Copies/mL (69 IU/mL) at Week 48 (Missing = Excluded Approach) [Time Frame: Week 48]
Endpoint(s): Percentage of Participants With Hepatitis B e Antigen (HBeAg) Seroconversion at Week 48 [Time Frame: Week 48] HBeAg seroconversion was defined as HBeAg loss and a change from HBeAb negative or missing at baseline to HBeAb positive., Percentage of Participants With Normal Alanine Aminotransferase (ALT) at Week 48, Based on the American Association for the Study of Liver Diseases (AASLD) Normal Range [Time Frame: Week 48] Normal ALT was defined as ≤ 30 U/L for males and females 0-12 years based on the AASLD pediatric normal range., Percentage of Participants With Normal ALT at Week 192, Based on the AASLD Normal Range [Time Frame: Week 192] Normal ALT was defined as ≤ 30 U/L for males and females 0-12 years based on the AASLD pediatric normal range., Percentage of Participants With Normal ALT at Week 48, Based on the Central Lab Normal Range [Time Frame: Week 48] Normal ALT was defined as ≤ 34 U/L for females aged 2-15 years old or males aged 1-9 years old, and ≤ 43 U/L for males aged 10-15 years old based on the central lab normal range., Percentage of Participants With Normal ALT at Week 192, Based on the Central Lab Normal Range [Time Frame: Week 192] Normal ALT was defined as ≤ 34 U/L for females aged 2-15 years old or males aged 1-9 years old, and ≤ 43 U/L for males aged 10-15 years old based on the central lab normal range., Percentage of Participants With Normalized ALT at Week 48, Based on the AASLD Normal Range [Time Frame: Week 48] Normal ALT was defined as ≤ 30 U/L for males and females 0-12 years based on the AASLD pediatric normal range. ALT normalization was defined as an ALT value that changed from above the normal range at baseline to within the normal range at the given postbaseline visit., Percentage of Participants With Normalized ALT at Week 192, Based on the AASLD Normal Range [Time Frame: Week 192] Normal ALT was defined as ≤ 30 U/L for males and females 0-12 years based on the AASLD pediatric normal range. ALT normalization was defined as an ALT value that changed from above the normal range at baseline to within the normal range at the given postbaseline visit., Percentage of Participants With Normalized ALT at Week 48, Based on the Central Lab Normal Range [Time Frame: Week 48] Normal ALT was defined as ≤ 34 U/L for females aged 2-15 years old or males aged 1-9 years old, and ≤ 43 U/L for males aged 10-15 years old based on the central lab normal range. ALT normalization was defined as an ALT value that changed from above the normal range at baseline to within the normal range at the given postbaseline visit., Percentage of Participants With Normalized ALT at Week 192, Based on the Central Lab Normal Range [Time Frame: Week 192] Normal ALT was defined as ≤ 34 U/L for females aged 2-15 years old or males aged 1-9 years old, and ≤ 43 U/L for males aged 10-15 years old based on the central lab normal range. ALT normalization was defined as an ALT value that changed from above the normal range at baseline to within the normal range at the given postbaseline visit., Composite Endpoint of Percentage of Participants With HBV DNA < 400 Copies/mL (69 IU/mL) and Normalized ALT (Based on AASLD Normal Range) at Week 48 [Time Frame: Week 48] Normal ALT was defined as ≤ 30 U/L for males and females 0-12 years based on the AASLD pediatric normal range. ALT normalization was defined as an ALT value that changed from above the normal range at baseline to within the normal range at the given postbaseline visit., Composite Endpoint of Percentage of Participants With HBV DNA < 400 Copies/mL (69 IU/mL) and Normalized ALT (Based on AASLD Normal Range) at Week 192 [Time Frame: Week 192] Normal ALT was defined as ≤ 30 U/L for males and females 0-12 years based on the AASLD pediatric normal range. ALT normalization was defined as an ALT value that changed from above the normal range at baseline to within the normal range at the given postbaseline visit., Composite Endpoint of Percentage of Participants With HBV DNA < 400 Copies/mL (69 IU/mL) and Normalized ALT (Based on Central Lab Normal Range) at Week 48 [Time Frame: Week 48], Normal ALT was defined as ≤ 34 U/L for females aged 2-15 years old or males aged 1-9 years old, and ≤ 43 U/L for males aged 10-15 years old based on the central lab normal range. ALT normalization was defined as an ALT value that changed from above the normal range at baseline to within the normal range at the given postbaseline visit., Composite Endpoint of Percentage of Participants With HBV DNA < 400 Copies/mL (69 IU/mL) and Normalized ALT (Based on Central Lab Normal Range) at Week 192 [Time Frame: Week 192], Normal ALT was defined as ≤ 34 U/L for females aged 2-15 years old or males aged 1-9 years old, and ≤ 43 U/L for males aged 10-15 years old based on the central lab normal range. ALT normalization was defined as an ALT value that changed from above the normal range at baseline to within the normal range at the given postbaseline visit., Percentage of Participants With HBV DNA < 169 Copies/mL (29 IU/mL) at Week 48 [Time Frame: Week 48], Percentage of Participants With HBV DNA < 169 Copies/mL (29 IU/mL) at Week 192 [Time Frame: Week 192], Percentage of Participants With HBsAg Loss at Week 48 [Time Frame: Week 48] HBsAg Loss was defined as a change from HBsAg positive or missing at baseline to HBsAg negative., Percentage of Participants With HBsAg Loss at Week 192 [Time Frame: Week 192] HBsAg Loss was defined as a change from HBsAg positive or missing at baseline to HBsAg negative., Percentage of Participants With HBsAg Seroconversion at Week 48 [Time Frame: Week 48] HBsAg seroconversion was defined as HBsAg loss and a change from HBsAb negative or missing at baseline to HBsAb positive., Percentage of Participants With HBsAg Seroconversion at Week 192 [Time Frame: Week 192] HBsAg seroconversion was defined as HBsAg loss and a change from HBsAb negative or missing at baseline to HBsAb positive., Number of Participants With Sequence Changes From Baseline Within the HBV Polymerase for Participants Who Were Viremic (HBV DNA ≥ 400 Copies/mL [69 IU/mL]) Including Participants With Confirmed Virologic Breakthrough at Week 48 [Time Frame: Baseline; Week 48], Number of Participants With Sequence Changes From Baseline Within the HBV Polymerase for Participants Who Were Viremic (HBV DNA ≥ 400 Copies/mL [69 IU/mL]) Including Participants With Confirmed Virologic Breakthrough at Week 96 [Time Frame: Baseline; Week 96], Number of Participants With Sequence Changes From Baseline Within the HBV Polymerase for Participants Who Were Viremic (HBV DNA ≥ 400 Copies/mL [69 IU/mL]) Including Participants With Confirmed Virologic Breakthrough at Week 144 [Time Frame: Baseline; Week 144], Number of Participants With Sequence Changes From Baseline Within the HBV Polymerase for Participants Who Were Viremic (HBV DNA ≥ 400 Copies/mL [69 IU/mL]) Including Participants With Confirmed Virologic Breakthrough at Week 192 [Time Frame: Baseline; Week 192], Percentage of Participants With ≥ 4% Decrease From Baseline in Spine Bone Mineral Density (BMD) at Week 48 [Time Frame: Baseline; Week 48], Percentage of Participants With ≥ 4% Decrease From Baseline in Spine BMD at Week 192 [Time Frame: Baseline; Week 192], Percent Change From Baseline in BMD of Spine at Week 48 [Time Frame: Baseline; Week 48], Percent Change From Baseline in BMD of Spine at Week 192 [Time Frame: Baseline; Week 192]

Source: https://euclinicaltrials.eu/ctis-public/view/2024-517526-26-00